EU clinical trial 2024-512186-14-00: Goal directed fluid removal with furosemide in intensive care patients with fluid overload: a randomised, blinded, placebo-controlled trial (GODIF)
Protocol code: GODIF trial
Sponsor: Region Hovedstaden (Hospital/Clinic/Other health care facility). Phase: Therapeutic use (Phase IV). Countries: Sweden (ended), Netherlands (ongoing, recruiting), Denmark (ongoing, recruiting), Czechia (ongoing, recruiting), Lithuania (ongoing, recruiting).
Therapeutic area(s): Diseases [C] - Pathological Conditions, Signs and Symptoms [C23]; Diseases [C] - Cardiovascular Diseases [C14]
Gender: Female, Male. Age: 18-64 years, 65+ years. Enrolment: 950.
Start date (EU): 2020-08-24. Decision date: 2024-09-05. Results received: No. Last updated: 2026-02-12.
Decision dates by country: NL: 2024-09-08, SE: 2024-09-05, DK: 2024-09-10, CZ: 2025-09-15, LT: 2025-10-29

Condition(s): Fluid overload/fluid accumulation
Product: In Denmark and The Netherlands, the trial is approved with trial drugs produced by the capital region pharmacy in Denmark which included both placebo and furosemide. the placebo is sodium chloride 0.9% for intravenous infusion. the sIMPD is up-loaded in the section below. Sweden has got the trial approved with sodium chloride 0.9% available in their departments with marketing authorisation. They perform the blinding and preparation of the trial drug on-site, for that reason the sIMPD is only relevant for Denmark and The Netherlands., Furosemide, FUROSEMIDE

Primary endpoint: The number of days alive and out of hospital at day 90
Endpoint(s): All-cause mortality at day 90; days alive without life support at day 90; number of participants with one or more serious adverse events and serious adverse reactions at day 90; all-cause mortality at 1 year; health-related quality of life at 1 year assessed by the EQ-5D-5L and EQ-VAS scores; participants subjective assessment of their quality of life at 1 year (unacceptable/neutral/acceptable); Cognitive function after 1 year assessed by the Montreal Cognitive Assessment test (MoCA 5 min)

Source: https://euclinicaltrials.eu/ctis-public/view/2024-512186-14-00